EU clinical trial 2024-515290-98-00: A Phase 2, Multiple Ascending Dose, Open-label, Proof-of-concept Study to Evaluate the Safety, Tolerability, Pharmacokinetics, and Activity of HM15136 Treatment for 8 Weeks in Subjects Aged ≥2 Years With Congenital Hyperinsulinism (CHI) (ACHIEVE)
Protocol code: HM-GCG-201
Sponsor: Hanmi Pharm. Co. Ltd. (Pharmaceutical company). Phase: Therapeutic exploratory (Phase II). Countries: Germany (ongoing, recruiting).
Therapeutic area(s): Diseases [C] - Nutritional and Metabolic Diseases [C18]
Gender: Female, Male. Age: 0-17 years, 18-64 years. Enrolment: 4.
Status: Ongoing, recruiting. Start date (EU): 2022-09-23. Decision date: 2024-07-09. Results received: No. Last updated: 2026-06-30.

Condition(s): Congenital Hyperinsulinism (CHI)

Primary endpoint: Safety and tolerability endpoints: 1. Incidence of adverse event (AE), treatment-emergent AE (TEAE), and serious AE (SAE) for the following: ° level of severity ° related to/not related to study drug ° leading to discontinuation of study drug ° AE of special interest ° death, 2. Incidence of clinical laboratory abnormalities, 3. Immunogenicity, 4. Incidence and severity of clinical findings on physical examination, 5. Change from baseline in vital signs (blood pressure, heart rate, respiratory rate, and body temperature), 6. Change from baseline in 12-lead ECG parameters; the primary ECG endpoint will be QT interval corrected for heart rate using Fridericia's formula (QTcF), Pharmacokinetic endpoints: 1. Maximum concentration (Cmax), 2. Time to reach Cmax (tmax), 3. Trough serum concentration (Ctrough), 4. Area under the concentration-time curve (AUC), eg, AUC from time 0 to time t (AUC0-t) at steady state during the period of injection, 5. Terminal elimination rate constant (kel), 6. Terminal half-life (t1/2), 7. Apparent clearance at steady state (CLss/F), 8. Apparent volume of distribution at steady state during the terminal phase (Vss/F)
Endpoint(s): Change from baseline in average weekly number and rate of level 1 or level 2 hypoglycemia events at Week 8 (Day 50 to Day 56) by the 7-point SMBG ° level 1 or level 2 hypoglycemia event: glucose <70 mg/dL (<3.9 mmol/L), Change from baseline in weekly rate of level 1 or level 2 hypoglycemia events in Diary ° level 1 or level 2 hypoglycemia event: glucose <70 mg/dL (<3.9 mmol/L) 44-week Optional Extension Treatment Period, Incidence of AE, TEAE, and SAE for the following: ° level of severity ° related to/not related to study drug ° leading to discontinuation of study drug ° AESIs ° death, Incidence of clinical laboratory abnormalities, Immunogenicity, Incidence and severity of clinical findings on physical examination, Change from baseline in vital signs (BP, HR, respiratory rate, and body temperature), Change from baseline in 12-lead ECG parameters; the primary ECG endpoint will be QTcF

Source: https://euclinicaltrials.eu/ctis-public/view/2024-515290-98-00